EU clinical trial 2024-516720-34-00: Study to evaluate the ability of a sublingual vaccine to induce the expression of trained immunity in peripheral blood cells
Protocol code: MV130-SLG-039
Sponsor: Inmunotek S.L. (Pharmaceutical company). Phase: Phase I and Phase II (Integrated)- Other. Countries: Spain (ongoing, recruiting).
Therapeutic area(s): Health Care [N] - Population Characteristics [N01]
Gender: Female, Male. Age: 18-64 years. Enrolment: 48.
Status: Ongoing, recruiting. Start date (EU): 2023-03-31. Decision date: 2024-10-30. Results received: No. Last updated: 2024-10-30.

Condition(s): Healthy adult males and non-pregnant females

Source: https://euclinicaltrials.eu/ctis-public/view/2024-516720-34-00